EU clinical trial 2023-506477-35-00: A Randomized, Double-Blind, Placebo-Controlled Study to Assess the Efficacy and Safety of SCD-044 in the Treatment of Moderate to Severe Plaque Psoriasis
Protocol code: SCD-044-19-14
Sponsor: Sun Pharmaceutical Industries Limited (Pharmaceutical company). Phase: Therapeutic exploratory (Phase II). Countries: Poland (ended), Estonia (ended).
Therapeutic area(s): Diseases [C] - Immune System Diseases [C20]
Gender: Female, Male. Age: 18-64 years, 65+ years. Enrolment: 63.
Status: Ended. Start date (EU): 2024-04-02. End date (EU): 2025-08-27. End date: 2025-08-28. Decision date: 2024-02-02. Results received: Yes. Last updated: 2024-10-23.
Decision dates by country: PL: 2024-02-02, EE: 2024-02-05

Condition(s): moderate to severe plaque psoriasis
Product: SCD-044 Tablets 0.3mg, SCD-044 Tablets 0.6mg, SCD-044 Tablets 1.0mg, SCD-044 Tablets 0.1mg, placebo to match SCD-044 tablets

Primary endpoint: Proportion of subjects with at least 75% improvement in PASI (PASI75) at Week 16

Source: https://euclinicaltrials.eu/ctis-public/view/2023-506477-35-00